EU clinical trial 2024-512301-16-01: The detection of tumor-associated fibrosis in colorectal peritoneal metastases by FAPI-PET (TROMPET)
Protocol code: 23U-0502
Sponsor: Universitair Medisch Centrum Utrecht (Hospital/Clinic/Other health care facility). Phase: Human Pharmacology (Phase I)- Other. Countries: Netherlands (ongoing, recruiting).
Therapeutic area(s): Analytical, Diagnostic and Therapeutic Techniques and Equipment [E] - Diagnosis [E01]; Analytical, Diagnostic and Therapeutic Techniques and Equipment [E] - Investigative Techniques [E05]; Diseases [C] - Digestive System Diseases [C06]
Gender: Female, Male. Age: 18-64 years, 65+ years. Enrolment: 25.
Status: Ongoing, recruiting. Start date (EU): 2024-12-12. Decision date: 2024-08-19. Results received: No. Last updated: 2026-03-03.

Condition(s): Metastatic colorectal cancer

Source: https://euclinicaltrials.eu/ctis-public/view/2024-512301-16-01